EU clinical trial 2023-509472-42-00: A Phase 3, Randomized, Multicenter, Open-label Study to Evaluate the Efficacy and Safety of Alnuctamab Compared to Standard of Care Regimens in Participants with Relapsed or Refractory Multiple Myeloma (RRMM) - ALUMMINATE RRMM
Protocol code: CA058-1019
Sponsor: Celgene International II S.a.r.l. (Pharmaceutical company). Phase: Therapeutic confirmatory (Phase III). Countries: Germany (ended), Italy (ended), Sweden (ended), Romania (ended), Ireland (ended), Czechia (ended), Spain (ended), France (ended), Hungary (ended), Portugal (ended), Belgium (ended), Austria (ended), Greece (ended), Norway (ended).
Therapeutic area(s): Diseases [C] - Neoplasms [C04]
Gender: Female, Male. Age: 18-64 years, 65+ years. Enrolment: 177.
Status: Ended. End date (EU): 2024-05-17. Decision date: 2024-04-16. Results received: Yes. Last updated: 2024-04-23.
Decision dates by country: AT: 2024-04-22, BE: 2024-04-19, CZ: 2024-04-16, FR: 2024-04-18, DE: 2024-04-17, GR: 2024-04-19, HU: 2024-04-19, IE: 2024-04-19, IT: 2024-04-17, PT: 2024-04-17, RO: 2024-04-19, ES: 2024-04-16, SE: 2024-04-16, NO: 2024-04-23

Condition(s): Relapsed and/or Refractory Multiple Myeloma
Product: Empliciti 400 mg powder for concentrate for solution for infusion., DARZALEX 1800 mg solution for injection, Alnuctamab, Imnovid 2 mg hard capsules, Alnuctamab, Imnovid 3 mg hard capsules, Imnovid 1 mg hard capsules, Kyprolis 60 mg powder for solution for infusion, Fortecortin® Inject 8 mg Injektionslösung in einer Ampulle, DEXAMETHASONE, Imnovid 4 mg hard capsules

Primary endpoint: The main thing the researchers are looking at is called "progression-free survival" (“PFS”). This means the time from when a person starts the treatment to when their cancer gets worse, or they die from any cause
Endpoint(s): They will also look at how long people live overall, which is called “overall survival” ("OS")., The researchers will also look at other things to see how well the treatment works. These include how well the cancer responds to the treatment, how long the cancer responds, and how long it takes for people to start a new treatment., They will also look at any side effects people have while taking the treatment and how it affects their quality of life., Overall, the researchers want to see if alnuctamab is a safe and effective treatment for people with multiple myeloma.

Source: https://euclinicaltrials.eu/ctis-public/view/2023-509472-42-00